EU clinical trial 2024-514686-19-00: A Multi-Center, Open Label, Uncontrolled, Phase 2a Clinical Trial Evaluating the Safety and Efficacy of the Addition of Ibrutinib to Venetoclax through a MRD-guided Approach in Relapsed/Refractory Patients with Chronic Lymphocytic Leukemia (CLL) IMPROVE (Ibrutinib treatment based on MRD-guided apPROach combined with VEnetoclax)
Sponsor: Ospedale San Raffaele S.r.l. (Hospital/Clinic/Other health care facility). Phase: Therapeutic exploratory (Phase II). Countries: Italy (ended).
Therapeutic area(s): Diseases [C] - Hemic and Lymphatic Diseases [C15]
Gender: Female, Male. Age: 18-64 years, 65+ years. Enrolment: 31.
Status: Ended. Start date (EU): 2017-03-10. End date (EU): 2026-02-10. Decision date: 2024-08-05. Results received: No. Last updated: 2024-08-05.

Condition(s): Relapsed or Refractory Chronic Lymphocytic Leukemia
Product: VENETOCLAX

Primary endpoint: Minimal residual disease (MRD) negativity rate evaluated by multi-colour flow cytometry analysis (limit of detection 10-4) within the treatment period

Source: https://euclinicaltrials.eu/ctis-public/view/2024-514686-19-00